EU clinical trial 2024-516591-15-00: Intravenous Fosfomycin in hospitalized patients with complicated urinary tract infections due to Third-generation cephalosporinresistant Enterobacterales
Sponsor: Azienda Ospedaliero Universitaria Di Modena (Hospital/Clinic/Other health care facility). Phase: Therapeutic use (Phase IV). Countries: Italy (ongoing, recruiting).
Therapeutic area(s): Diseases [C] - Bacterial Infections and Mycoses [C01]
Gender: Female, Male. Age: 18-64 years, 65+ years. Enrolment: 548.
Status: Ongoing, recruiting. Start date (EU): 2024-11-12. Decision date: 2024-11-12. Results received: No. Last updated: 2026-06-05.

Condition(s): urinary tract infections
Product: FOSFOMYCIN, ERTAPENEM, PIPERACILLIN AND BETA-LACTAMASE INHIBITOR

Primary endpoint: Clinical Response (CR) defined as clinical and microbiological cure (CMC) at 5 to 7 days after finalization of treatment (test of cure, TOC)
Endpoint(s): Clinical cure rates in the 2 treatment groups in MITT, m-MITT, clinical evaluable, and microbiologic evaluable populations at TOC;clinical evaluation after 48 h from first drug administration;microbiological eradication rates in m-MITT and ME populations at TOC;Mortality for any reason until day 30;Hospital readmissions or extended hospitalization; Number of hospital re-admissions until day 90;Relapse or reinfections;Clostridioides difficile associated diarrhea;AE related to fosfomycin treatment

Source: https://euclinicaltrials.eu/ctis-public/view/2024-516591-15-00